EU clinical trial 2024-514494-21-00: A Multicenter Randomized, Controlled, Double-blinded Trial to Evaluate Efficacy and Safety of Bortezomib in Patients With Severe Autoimmune Encephalitis
Protocol code: ZKSJ0120
Sponsor: Friedrich-Schiller-Universitaet Jena (Educational Institution). Phase: Therapeutic exploratory (Phase II). Countries: Germany (ongoing, recruiting).
Therapeutic area(s): Diseases [C] - Immune System Diseases [C20]
Gender: Female, Male. Age: 18-64 years, 65+ years. Enrolment: 50.
Status: Ongoing, recruiting. Start date (EU): 2020-05-13. Decision date: 2024-06-27. Results received: No. Last updated: 2026-06-10.

Condition(s): autoimmune encephalitis
Product: SALINE, BORTEZOMIB

Primary endpoint: mRS 17 weeks after first administration of the investigational product
Endpoint(s): mRS and GCS 3, 6, 9 and 13 weeks after first administration of the investigational product; GCS 17 weeks after first administration of the investigational product, Length of stay in hospital/intensive care unit, Antibody titers and destruction markers (in serum and cerebrospinal fluid), cellular immune response (FACS, in cerebrospinal fluid) at the baseline visit and 17 weeks after first administration of the investigational product, Neurocognitive function (MoCA, MMST, VLMT and NPI) at the baseline visit and 17 weeks after the first visit and 17 weeks after first administration of the investigational product, Number of all (serious) adverse events within 17 weeks after the first 17 weeks after first administration of the investigational product, Bortezomib safety with regard to polyneuropathy, increase in liver enzymes liver enzymes, hematotoxicity, gastrointestinal toxicity and secondary infections.

Source: https://euclinicaltrials.eu/ctis-public/view/2024-514494-21-00